EU clinical trial 2024-514026-23-00: JAK Inhibition in PReclinical Arthritis
Sponsor: Universitaetsklinikum Erlangen AöR (Hospital/Clinic/Other health care facility). Phase: Therapeutic exploratory (Phase II). Countries: Germany (ended).
Therapeutic area(s): Diseases [C] - Musculoskeletal Diseases [C05]
Gender: Female, Male. Age: 18-64 years, 65+ years. Enrolment: 20.
Status: Ended. Start date (EU): 2023-09-06. End date (EU): 2026-06-18. Decision date: 2024-05-17. Results received: No. Last updated: 2026-02-02.

Condition(s): preclinical phase of rheumatoid arthritis
Product: Baricitinib-Placebo ident appearance, BARICITINIB

Primary endpoint: Number of patients with development of arthritis at week 48
Endpoint(s): Number of patients with development of arthritis at week 24, Fulfillment of the ACR/EULAR 2010 RA classification criteria, Ultrasound: number of patients without signs of PD synovitis or PD tenosynovitis at week 24 and week 48 compared to baseline and compared within both groups, Safety: (S)AE, Subjective (SACRAH, sMHQ) and objective (moberg pick up test (MPUT)) hand function, Change in anti CCP2 antibody levels (RE/ml)

Source: https://euclinicaltrials.eu/ctis-public/view/2024-514026-23-00